EU clinical trial 2023-505183-10-00: A PHASE 2, MULTI-COHORT, OPEN-LABEL, MULTICENTER STUDY TO EVALUATE THE EFFICACY AND SAFETY OF BB2121 IN SUBJECTS WITH RELAPSED AND REFRACTORY MULTIPLE MYELOMA AND IN SUBJECTS WITH CLINICAL HIGH-RISK MULTIPLE MYELOMA
Protocol code: bb2121-MM-002
Sponsor: Celgene Corp. (Pharmaceutical company). Phase: Therapeutic exploratory (Phase II). Countries: Spain (ended), France (ended), Germany (ended).
Therapeutic area(s): Diseases [C] - Neoplasms [C04]
Gender: Female, Male. Age: 18-64 years, 65+ years. Enrolment: 20.
Status: Ended. Start date (EU): 2019-01-04. End date (EU): 2025-10-14. End date: 2026-01-15. Decision date: 2024-02-12. Results received: No. Last updated: 2025-09-22.
Decision dates by country: ES: 2024-02-12, FR: 2024-02-12, DE: 2024-02-13

Condition(s): Relapsed and refractory multiple myeloma (RRMM), multiple myeloma (MM) with progression within 18 months of initial treatment/ or newly diagnosed multiple myeloma (NDMM) with suboptimal response post autologous stem cell transplant (ASCT) (Cohort 3 only)
Product: idecabtagene vicleucel

Primary endpoint: Overall response rate (ORR) (Cohort 1), Complete response (CR) rate Cohort 1b,Cohort2a,Cohort 2b,Cohort 2c,and Cohort 3
Endpoint(s): Complete response (CR) rate (Cohort 1), Overall response rate (ORR) Cohort 1b, 2a, b,cand Cohort 3, Very good partial response (VGPR) rate (Cohort 2c), Time to response (TTR), Duration of response (DoR), Progression-free survival (PFS), Time to progression (TTP), Overall survival (OS), Pharmacokinetics, Immunogenicity, Health-related Quality of Life (HRQoL), Feasibility of lenalidomide maintenance therapy post-bb2121 infusion (Cohort 3)

Source: https://euclinicaltrials.eu/ctis-public/view/2023-505183-10-00